EU clinical trial 2024-517152-34-00: Intraperitoneal irinotecan with concomitant FOLFOX and bevacizumab for patients with unresectable colorectal peritoneal metastases – a phase II study
Sponsor: Catharina Ziekenhuis Stichting (Hospital/Clinic/Other health care facility). Phase: Therapeutic exploratory (Phase II). Countries: Netherlands (ongoing, recruitment ended).
Therapeutic area(s): Diseases [C] - Neoplasms [C04]; Analytical, Diagnostic and Therapeutic Techniques and Equipment [E] - Therapeutics [E02]
Gender: Female, Male. Age: 18-64 years, 65+ years. Enrolment: 85.
Status: Ongoing, recruitment ended. Start date (EU): 2026-06-19. Decision date: 2024-09-03. Results received: No. Last updated: 2024-09-03.

Condition(s): Irresectable peritoneal metastases of colorectal cancer
Product: Irinotecan Hydrochloride 20 mg/ml concentrate for solution for infusion

Primary endpoint: To determine the anti-tumor activity in patients treated with intraperitoneal irinotecan (75 mg) and concomitant palliative systemic therapy, in terms of overall survival (calculated from (a) the interval from diagnosis of peritoneal metastases until death or last follow-up; (b) the interval from the first day of the first cycle until death or last follow-up).

Source: https://euclinicaltrials.eu/ctis-public/view/2024-517152-34-00